EU clinical trial 2023-504330-21-00: A study to assess safety and efficacy of SOT201 in patients with advance/metastatic cancer
Protocol code: SC201 (VICTORIA-01)
Sponsor: SOTIO Biotech AG (Pharmaceutical company). Phase: Human Pharmacology (Phase I)- First administration to humans. Countries: Belgium (ongoing, recruiting), Czechia (ongoing, recruiting), Spain (ongoing, recruiting).
Therapeutic area(s): Diseases [C] - Neoplasms [C04]
Gender: Female, Male. Age: 18-64 years, 65+ years. Enrolment: 32.
Status: Ongoing, recruiting. Start date (EU): 2024-07-22. Decision date: 2024-04-17. Results received: No. Last updated: 2026-05-05.
Decision dates by country: ES: 2024-04-19, CZ: 2024-04-18, BE: 2024-04-17

Condition(s): advanced/metastatic solid tumors

Source: https://euclinicaltrials.eu/ctis-public/view/2023-504330-21-00